EU clinical trial 2024-514880-25-00: Prospective, multicenter, open-label study to evaluate the efficacy of esmolol in the early identification of cardiovascular disorders induced by cirrhosis, diabetes mellitus, and cardiotoxic treatments.
Protocol code: CIBER-bB-ECHO
Sponsor: Consorcio Centro De Investigacion Biomedica En Red (Laboratory/Research/Testing facility). Phase: Therapeutic confirmatory (Phase III). Countries: Spain (ongoing, recruiting).
Therapeutic area(s): Diseases [C] - Cardiovascular Diseases [C14]; Diseases [C] - Nutritional and Metabolic Diseases [C18]
Gender: Female, Male. Age: 18-64 years, 65+ years. Enrolment: 1000.
Status: Ongoing, recruiting. Start date (EU): 2024-06-27. Decision date: 2024-06-27. Results received: No. Last updated: 2024-06-27.

Condition(s): Patients with cardiovascular alterations induced by cirrhosis, diabetes mellitus and cardiotoxic treatments.
Product: BREVIBLOC 10 mg/ml, solution pour perfusion

Primary endpoint: To determine the reduction in variability in the measurement of LV systolic function obtained by the combination of acute adrenergic blockade. This reduction variability will be studied with reference to two conventional indices (EF and global longitudinal strain) and an alternative index (IVPD-IVUS)., To establish patterns of normality and physiological changes in the measurement of myocardial function during a longitudinal period in patients and healthy subjects, obtained at baseline and after administration of esmolol., To compare the diagnostic accuracy (ROC curve analysis) of esmolol echocardiography with baseline echocardiography to identify patients with myocardial damage associated with DM2 (with and without ICFEN) and advanced cirrhosis., To compare the predictive ability of esmolol echocardiography with baseline echocardiography for the prediction of antineoplastic-induced cardiotoxicity., To study the incremental value of molecular biomarkers for characterization by smololol echocardiography and for establishing diagnostic and prognostic criteria in patients with DM2, cirrhosis and cancer., To analyze whether the degree of neurohumoral activation, inflammation and myocardial damage characterized by blood biomarkers condition the response to esmolol and the characterization of systolic function in different groups of patients., To evaluate the added value of the combination of systolic function parameters determined by imaging techniques and circulating biomarkers for the diagnosis of myocardial involvement and prediction of events in different patient groups.
Endpoint(s): The secondary prognostic endpoint is defined as the superiority of cardiac function measures obtained under esmolol infusion (IVPAD, EF and strain) over baseline measures in predicting the incidence of major cardiac events (cardiovascular death, development of HF) at 3 years of follow-up (prognostic efficacy)., To analyze the prognostic implications of determining the degree of detectable sympathetic hyperactivity at the cardiac level by changes in systolic function obtained immediately pre- and post-smolol in patients with DM2, cirrhosis and cancer., The use of multi-modality imaging and plasma biomarkers in combination for targets present at the primary endpoint, as well as sensitivity and mediation analysis to see the incremental value of each modality.

Source: https://euclinicaltrials.eu/ctis-public/view/2024-514880-25-00